EU clinical trial 2024-517000-11-00: ASSESSMENT OF THE EFFICACY IN REDUCING EDEMA, TRISMUS AND PAIN, OF DEXAMETHASONE ACCORDING TO DIFFERENT INTRAORAL AND EXTRAORAL PREOPERATIVE APPLICATION ROUTES, IN THE SURGERY OF RETAINED LOWER THIRD MOLARS.
Protocol code: COR-24
Sponsor: Complutense University Of Madrid (Educational Institution). Phase: Therapeutic use (Phase IV). Countries: Spain (authorised, recruitment pending).
Therapeutic area(s): Diseases [C] - Disorders of Environmental Origin [C21]; Analytical, Diagnostic and Therapeutic Techniques and Equipment [E] - Diagnosis [E01]
Gender: Female, Male. Age: 18-64 years. Enrolment: 3.
Status: Authorised, recruitment pending. Decision date: 2025-03-14. Results received: No. Last updated: 2025-03-14.

Condition(s): Third molar extraction
Product: DEXAMETHASONE, DEXAMETHASONE

Primary endpoint: One year follow-up

Source: https://euclinicaltrials.eu/ctis-public/view/2024-517000-11-00